EU clinical trial 2023-507352-72-00: Prospective Analysis of Pharmacokinetic Infliximab data in Paediatric Inflammatory Bowel Disease patients (Pro-RAPID)
Protocol code: NL81536.078.22
Sponsor: Erasmus Universitair Medisch Centrum Rotterdam (Erasmus MC) (Hospital/Clinic/Other health care facility). Phase: Therapeutic use (Phase IV). Countries: Netherlands (ongoing, recruiting).
Therapeutic area(s): Diseases [C] - Digestive System Diseases [C06]
Gender: Female, Male. Age: 0-17 years. Enrolment: 50.
Status: Ongoing, recruiting. Start date (EU): 2024-05-24. Decision date: 2024-05-23. Results received: No. Last updated: 2026-04-07.

Condition(s): Crohn's Disease
Product: Remsima 100 mg powder for concentrate for solution for infusion

Primary endpoint: The primary endpoint is the proportion of patients with IFX TL ≥ 5 µg/mL at week 12 without treatment escalation.
Endpoint(s): Proportion of patients with IFX TL ≥ 5 µg/mL at week 24 without the need for treatment escalation,proportion of patients in clinical and/or biochemical remission at weeks 4, 12, and week 24 without the need for treatment escalation in patients with TL > 5 µg/mL and in patients with TL < 5 µg/mL, predictors of IFX TLs at weeks 4, 12, and 24

Source: https://euclinicaltrials.eu/ctis-public/view/2023-507352-72-00